EU clinical trial 2024-513159-33-00: Comparison of albumin and Ringer´s solution for optimization of the plasma volume and hemodynamics during surgery
Sponsor: Region Oestergoetland (Hospital/Clinic/Other health care facility). Phase: Therapeutic use (Phase IV). Countries: Sweden (ongoing, recruiting).
Therapeutic area(s): Analytical, Diagnostic and Therapeutic Techniques and Equipment [E] - Anesthesia and Analgesia [E03]
Gender: Female, Male. Age: 18-64 years, 65+ years. Enrolment: 60.
Status: Ongoing, recruiting. Start date (EU): 2023-09-26. Decision date: 2024-04-26. Results received: No. Last updated: 2025-10-22.

Condition(s): fluid therapy in combination laparoscopic surgery
Product: ELECTROLYTES, ALBUMIN

Primary endpoint: Hemoglobinsänkning i samband med vätskebolus, vilken bearbetas matematiskt i en kinetisk modell.
Endpoint(s): Cirkulationsfysiologiska mätningar. Förändring i P-albumin, P-Kreatinin, Vätskesammansättning och vätskebalans preoperativt och efter ett dygn.

Source: https://euclinicaltrials.eu/ctis-public/view/2024-513159-33-00